EU clinical trial 2023-506933-32-00: KEYMAKER-U01 Master Study: A Phase 2, Umbrella Study with Rolling Arms of Investigational Agents with either Pembrolizumab in Combination with Chemotherapy or with Pembrolizumab Alone in Patients with Advanced Non-small Cell Lung Cancer (NSCLC); KEYMAKER-U01 Substudy 2: A Phase 2, Umbrella Study with Rolling Arms of Investigational Agents in Combination with Pembrolizumab in Treatment Naïve Patients with PD-L1 Positive Advanced Non-small Cell Lung Cancer (NSCLC)
Protocol code: MK-3475-01B
Sponsor: Merck Sharp & Dohme LLC (Pharmaceutical company). Phase: Therapeutic exploratory (Phase II). Countries: Hungary (ended), Italy (ended), Spain (ended), Poland (ended).
Therapeutic area(s): Diseases [C] - Neoplasms [C04]
Gender: Female, Male. Age: 18-64 years, 65+ years. Enrolment: 38.
Status: Ended. Start date (EU): 2020-10-20. End date (EU): 2025-10-24. End date: 2025-10-31. Decision date: 2024-01-10. Results received: No. Last updated: 2025-11-11.
Decision dates by country: PL: 2024-06-10, ES: 2024-01-23, IT: 2024-02-01, HU: 2024-01-10

Condition(s): Non-small Cell Lung Cancer (NSCLC)
Product: rolistobart, MK-4830, KEYTRUDA 25 mg/mL concentrate for solution for infusion, MK-4830

Primary endpoint: Objective Response Rate (ORR) According to Response Evaluation Criteria in Solid Tumors Version 1.1 (RECIST 1.1)
Endpoint(s): Progression-Free Survival (PFS) According to Response Evaluation Criteria in Solid Tumors Version 1.1 (RECIST 1.1), Number of Participants Who Experience One or More Adverse Events (AEs), Number of Participants Who Discontinued Study Treatment Due to an Adverse Event (AE)

Source: https://euclinicaltrials.eu/ctis-public/view/2023-506933-32-00